EU clinical trial 2023-504446-58-00: Effect of Treatment with Finerenone on Cardio-Renal Target Organ Damage in Patients with Type 2 Diabetes – A Randomized Trial
Protocol code: FineCaRe
Sponsor: Aarhus University Hospital (Hospital/Clinic/Other health care facility). Phase: Therapeutic use (Phase IV). Countries: Denmark (ongoing, recruiting).
Therapeutic area(s): Diseases [C] - Hormonal diseases [C19]; Diseases [C] - Cardiovascular Diseases [C14]; Diseases [C] - Eye Diseases [C11]; Diseases [C] - Nutritional and Metabolic Diseases [C18]
Gender: Female, Male. Age: 18-64 years, 65+ years. Enrolment: 80.
Status: Ongoing, recruiting. Start date (EU): 2024-10-15. Decision date: 2024-09-17. Results received: No. Last updated: 2025-03-17.

Condition(s): Type 2 diabetes, chronic kidney disease
Product: Kerendia 10 mg film coated tablets, Placebo til finerenon kapsel 10 mg

Primary endpoint: Change in left ventricular mass measured by non-contrast cardiac MRI., Change in albuminuria measured by urinary albumin-to-creatinine ratio (UACR) in morning spot urine samples (first morning voids).
Endpoint(s): Change in the rate of myocardial fibrosis (extracellular cardiac volume – ECV %) measured by MRI of the heart using gadolinium-containing contrast., Change in the rate of myocardial fibrosis measured by non-contrast T1-mapping, measured by non-contrast MRI of the heart., Change in left ventricular ejection fraction (EF), left ventricular and atrial volumes measured by non-contrast MRI of the heart., Change in the rate of pulse wave velocity in the aorta measured by non-contrast MRI of the heart., Change in arterial stiffness assessed as carotid-femoral pulse wave velocity., Change in 24-hour blood pressure., Change in inflammatory and fibrotic biomarkers related to cardiovascular disease measured in blood and urine., Change in measured glomerular filtration rate (mGFR) assessed by injection of a tracer., Change in eGFR slope including all available outpatient eGFR measured a) from before treatment to last day of treatment b) from 4 weeks after treatment initiation to last day after treatment., Change in UACR by repeated measures analysis including all available outpatient UACR measurements from before treatment to the last day after treatment., Change in markers of the renin-angiotensin-aldosterone system measured in blood and urine., Change in inflammatory and fibrotic biomarkers related to chronic kidney disease (e.g. markers of renal tubule damage) measured in blood and urine., Change in kidney microstructure and fibrosis assessed as changes in T1-mapping and changes in the rate of apparent diffusion coefficient (ADC)-values of diffusion-weighted MRI of the kidneys using non-contrast MRI., Change in renal oxygenation assessed by BOLD MRI and change in renal perfusion with a pseudo continuous arterial spin labeling (pCASL), both non-contrast MR techniques., Change in kidney size measured by a Dixon water/fat sequence MRI, a non-contrast MRI technique., Change in thoracic aortic wall volume (TWV) measured by MRI of the heart.

Source: https://euclinicaltrials.eu/ctis-public/view/2023-504446-58-00